EU clinical trial 2023-505881-27-00: A Study to Estimate the Effect of Multiple Doses of Carbamazepine on the PK of Single Dose Vepdegestrant in Healthy Adult Participants
Protocol code: C4891011
Sponsor: Pfizer Inc. (Pharmaceutical company). Phase: Human Pharmacology (Phase I)- Other. Countries: Belgium (ended).
Therapeutic area(s): Diseases [C] - Neoplasms [C04]
Gender: Female, Male. Age: 18-64 years, 65+ years. Enrolment: 12.
Status: Ended. Start date (EU): 2023-08-14. End date (EU): 2023-11-21. End date: 2023-11-22. Decision date: 2023-08-07. Results received: No. Last updated: 2023-11-28.

Condition(s): ER+/HER2 positive breast cancer

Source: https://euclinicaltrials.eu/ctis-public/view/2023-505881-27-00